EU clinical trial 2023-508537-13-01: Gabapentin for sub-acute radicular leg pain (GABARAD)
Sponsor: Rigshospitalet (Hospital/Clinic/Other health care facility). Phase: Therapeutic confirmatory (Phase III). Countries: Denmark (ongoing, recruiting).
Therapeutic area(s): Diseases [C] - Musculoskeletal Diseases [C05]
Gender: Female, Male. Age: 18-64 years, 65+ years. Enrolment: 200.
Status: Ongoing, recruiting. Start date (EU): 2025-01-20. Decision date: 2024-03-27. Results received: No. Last updated: 2025-06-10.

Condition(s): radicular leg pain
Product: Gabapentin ”Orifarm”, hårde kapsler, GELATIN

Primary endpoint: Change in average leg pain intensity (measured on a numeric rating scale (NRS) from 0 to 10 over the last 24 hours) from baseline to week 6, based on least squares means and standard errors derived from the primary repeated measures mixed linear model, adjusted for baseline values.
Endpoint(s): Change from baseline to the 6 weeks assessment in aA (NRS - at 1, 2, 4 weeks)maximal leg pain, average back NRS pain and changes in NRS pain last 24 hours, pain related disability (ODIswestry), general health, (all 1, 2, 4, 6 weeks) with least squares means and standard errors derived estimates derived from the main repeated measures mixed linear model, adjusted for baseline values., Change in work status during the 6 week treatment period compared between Gabapentin and placebo., Occurence of AEs and SAEs in Gabapentin compared to placebo, Intake of other analgesics compared between the Gabapentin and placebo group during a 6 weeks treatment period.

Source: https://euclinicaltrials.eu/ctis-public/view/2023-508537-13-01